EU clinical trial 2024-514875-16-00: Reduction in the number of chemotherapy cycles in combination with Pembrolizumab in first-line treatment of PD-L1-positive recurrent or metastatic head and neck squamous cell carcinomas
Protocol code: 24VADS04
Sponsor: Oncopole Claudius Regaud (Hospital/Clinic/Other health care facility). Phase: Therapeutic exploratory (Phase II). Countries: France (ongoing, recruiting).
Therapeutic area(s): Diseases [C] - Neoplasms [C04]
Gender: Female, Male. Age: 18-64 years, 65+ years. Enrolment: 86.
Status: Ongoing, recruiting. Start date (EU): 2024-10-21. Decision date: 2024-08-13. Results received: No. Last updated: 2026-05-22.

Condition(s): First-line treatment of PD-L1-positive recurrent or metastatic head and neck squamous cell carcinomas
Product: KEYTRUDA 25 mg/mL concentrate for solution for infusion, FLUOROURACILE ACCORD 50 mg/ml, solution à diluer pour perfusion, CARBOPLATINE ACCORD 10 mg/ml, solution pour perfusion, CISPLATINE ACCORD 1 mg/ml, solution à diluer pour perfusion

Primary endpoint: The co-primary endpoint for the activity is the objective response rate. It will be presented using number, percentage and one-sided 95% confidence interval (Binomial exact)., The co-primary endpoint for the safety is the rate of patients with AE leading to any treatment discontinuation. It will be presented using number, percentage and one-sided 95% confidence interval (Binomial exact).
Endpoint(s): The objective response rate at 6 months is defined by the presence of an objective response (i.e. complete or partial response) at 6 months according to the RECIST v1.1 criteria, assessed by the investigator. It is defined by the ratio of the number of patients presenting an objective response at 6 months to the total number of patients., Progression-free survival is defined by the time between the date of inclusion and the date on which a first tumor confirmed progression is documented (according to RECIST v1.1 criteria, (Eisenhauer, 2009)) or death from any causes. Patients alive and progression free on the date of last news will be censored on the date of last tumor assessment., Overall survival is defined by the time between the date of inclusion and the date of death from any cause or the date of the last news (Censored Data)., Duration of response is defined in the population of patients with an objective response. It is defined by the time between the date of confirmed objective response and the date on which a first confirmed tumor progression is documented (according to RECIST v1.1 criteria, Eisenhauer, 2009) or death from all causes. Patients alive and progression free at last news will be censored on the date of last tumor assessment., Safety will be assessed according to the toxicity grading of NCI CTCAE v 5.0.

Source: https://euclinicaltrials.eu/ctis-public/view/2024-514875-16-00